EU clinical trial 2023-508935-30-00: Use of oral colchicine to determine restenosis in the superficial femoral artery - the COLSTENT study
Protocol code: COLSTENT_2023
Sponsor: Uniwersytecki Szpital Kliniczny W Opolu (Hospital/Clinic/Other health care facility). Phase: Therapeutic confirmatory (Phase III). Countries: Poland (ongoing, recruiting).
Therapeutic area(s): Diseases [C] - Cardiovascular Diseases [C14]
Gender: Female, Male. Age: 18-64 years, 65+ years. Enrolment: 284.
Status: Ongoing, recruiting. Start date (EU): 2025-11-20. Decision date: 2024-04-29. Results received: No. Last updated: 2025-07-28.

Condition(s): Lower extremity artery disease
Product: COLCHICINE

Primary endpoint: Patency of the superficial femoral artery after 24 months. Number of patients in whom the superficial femoral artery remained patency, i.e. blood flow in the artery assessed by Doppler ultrasound examination is three-phase and fast-flow 24 months after its implantation, Overall risk assessment of the procedure performed, defined as the number of subjects who experienced adverse events (AEs and SAEs), regardless of the potential connection with the stent implantation procedure or the pharmacotherapy used.
Endpoint(s): Target Vessel Revascularization (TVR) over 24 months. Number of patients whose target vascular lesion in the superficial femoral artery required repeated revascularization within 24 months of stent implantation., Late Lumen Loss (LLL) after 6 months. The value of the difference in mm between the minimum lumen diameter (MLD) in the stent immediately after stenting and the MLD 6 months after stent implantation., Percentage narrowing of the vessel diameter in the stent after 24 months. Change estimated in % of the minimum lumen diameter in the stent (MLD) immediately after stenting and 24 months after stent implantation, determined by the formula [1−(MLD/reference vessel diameter)×100], Improvement of the ankle-brachial index (ABI) after 24 months. Number of patients with an increase in the ankle-brachial index value by 0.1 during 24 months after stent implantation., Improved Rutherford ischemia classification after 24 months. Number of patients whose ischemia classification on the Rutherford scale was reduced by one class within 24 months after stent implantation., Occurrence of major amputation after 24 months. Number of patients who underwent amputation involving detachment of the ankle joint, amputation below/above the knee within 24 months of stent implantation., Major adverse cardiovascular events (MACE) after 24 months. Number of patients who experienced myocardial infarction, coronary revascularization, ischemic stroke or death from cardiovascular causes within 24 months after stent implantation, Occurrence of death from cardiovascular causes after 24 months. Number of patients who died of cardiovascular causes within 24 months after stent implantation., Number of days of hospitalization (all causes) during 24 months. Number of days of hospitalization of the patient for any reason within 24 months after stent implantation, Number of hospitalization days related to LEAD in the stented leg during 24 months. Number of days of patient hospitalization related to LEAD in the leg with an implanted stent, including repeated revascularization, amputation, etc. within 24 months of implantation, Improvement in ischemic pain intensity assessed using the NRS scale after 24 months. Reduction in the intensity of ischemic pain assessed using the NRS scale in relation to baseline values by 10 pp in the period of 24 months after stent implantation, Improvement in quality of life assessed using the VascuQol protocol at 24 months. An increase in the quality of life assessed using the VascuQol scale during the study compared to the baseline values by 10 pp in the 24 months after stent implantation

Source: https://euclinicaltrials.eu/ctis-public/view/2023-508935-30-00